EU clinical trial 2023-509673-22-00: Phase Ib study combining dinutuximab beta with induction chemotherapy regimens in patients with newly diagnosed high-risk neuroblastoma: SIOPEN-Pilot01
Protocol code: SIOPEN-Pilot01
Sponsor: Prinses Maxima Centrum voor Kinderoncologie B.V. (Hospital/Clinic/Other health care facility). Phase: Phase I and Phase II (Integrated)- Other. Countries: Netherlands (ongoing, recruiting), France (ongoing, recruiting), Germany (authorised, recruitment pending), Spain (ongoing, recruiting), Austria (authorised, recruiting), Italy (ongoing, recruiting), Poland (authorised, recruitment pending).
Therapeutic area(s): Diseases [C] - Neoplasms [C04]
Gender: Female, Male. Age: 0-17 years. Enrolment: 39.
Start date (EU): 2024-12-02. Decision date: 2024-06-22. Results received: No. Last updated: 2025-09-11.
Decision dates by country: FR: 2025-04-10, DE: 2025-04-10, ES: 2025-03-21, AT: 2025-07-14, IT: 2025-07-10, PL: 2025-07-14, NL: 2024-06-22

Condition(s): Neuroblastoma
Product: Etoposide 20 mg/ml Concentrate for Solution for Infusion, Sodium Chloride 0.9% Intravenous Infusion BP, Vincristine Sulfate 1 mg/ml Solution for Injection or Infusion, Doxorubicin Teva 2 mg/ml Concentrate for Solution for Infusion, Cisplatin 1 mg/ml Concentrate for Solution for Infusion, Human Albumin Baxalta 50 g/l Solution for Infusion, Cyclophosphamide 1000 mg Powder for Solution for Injection or Infusion, Qarziba 4.5 mg/mL concentrate for solution for infusion, Dacarbazine Lipomed 200 mg powder for solution for injection or infusion, Water for Injections Ph. Eur., Mitoxana 1 g Powder for Sterile Concentrate, Eldisine Powder for Solution for Injection 5.0 mg, Glucose 5% Intravenous Infusion BP, Carboplatin 10 mg/ml concentrate for solution for infusion

Primary endpoint: Incidence of dose limiting toxicities (DLTs) associated with the combination of dinutuximab beta with GPOH (2 DLT evaluation cycles: first N6 and second N5 cycles) or rapid COJEC (first C and second B and A cycles) induction chemotherapy regimens.
Endpoint(s): Type, incidence, severity, seriousness and relationship to study medications for Grade 3 and 4 AEs, including laboratory abnormalities and severe adverse events (SAEs). • Cumulative incidence of treatment-related mortality and of disease-related mortality., Overall response during and after induction (primary tumor, metastases)., mCR after induction treatment. mPR according to eligibility criteria to proceed to consolidation by HDC/ASCT: mPR for bone disease: MIBG uptake (or FDG-PET uptake for MIBG-non avid tumors) completely resolved or SIOPEN score ≤3 and at least 50% reduction in MIBG score (or ≤3 bone lesions and at least 50% reduction in number of FDG-PET-avid bone lesions for MIBG-non avid tumors). mPR for bone marrow disease: CR and/or MD according to INRC. mPR for other metastatic sites

Source: https://euclinicaltrials.eu/ctis-public/view/2023-509673-22-00